EU clinical trial 2024-518407-22-00: Clinical Trial To Determine The Efficacy And Safety Of Insulin Eye Drops In Dry Eye In Patients With Topical Hypotensors
Protocol code: 01INSULINAGLAUCOMA20
Sponsor: Hospital Clinico San Carlos (Hospital/Clinic/Other health care facility). Phase: Therapeutic use (Phase IV). Countries: Spain (ended).
Therapeutic area(s): Diseases [C] - Eye Diseases [C11]
Gender: Female, Male. Age: 18-64 years, 65+ years. Enrolment: 100.
Status: Ended. Start date (EU): 2023-02-08. End date (EU): 2026-03-27. Decision date: 2024-10-16. Results received: No. Last updated: 2024-10-16.

Condition(s): Dry eye disease
Product: ARTIFICIAL TEARS AND OTHER INDIFFERENT PREPARATIONS, INSULIN (HUMAN)

Primary endpoint: Changes in dry eye symptoms from baseline to 6 months after treatment time
Endpoint(s): Change of corneal staining from baseline to 6 months after treatment, Change in corneal aesthesiometry from baseline to 6 months after treatment, Change in conjunctival hyperemia from baseline to 6 months after treatment, Change in non-invasive tear film break-up time from baseline to 6 months after treatment, Change in light dispersion from baseline to 6 months after treatment, Change in cytokine levels from baseline to 6 months after treatment, Changes in therapeutic compliance with hypotensive treatment, Proportion of patients presenting adverse effects

Source: https://euclinicaltrials.eu/ctis-public/view/2024-518407-22-00